EU clinical trial 2025-523369-32-00: A study to evaluate the dose-exposure, safety, and exploratory efficacy of nerandomilast in children and adolescents from 2 years to less than 18 years of age with fibrosing interstitial lung disease (Part A: double-blind, placebo-controlled in children from 6 to less than 18 years of age and open-label active treatment in children from 2 to less than 6 years of age), followed by an open-label phase with active treatment (Part B)
Protocol code: 1305-0022
Sponsor: Boehringer Ingelheim International GmbH, Boehringer Ingelheim Espana S.A. (Pharmaceutical company). Phase: Therapeutic confirmatory (Phase III). Countries: Belgium (authorised, recruitment pending), Greece (authorised, recruitment pending), Germany (authorised, recruitment pending), France (authorised, recruitment pending), Finland (authorised, recruitment pending), Spain (ongoing, recruiting), Czechia (authorised, recruitment pending), Poland (authorised, recruitment pending), Italy (authorised, recruitment pending), Netherlands (authorised, recruitment pending), Denmark (authorised, recruitment pending), Portugal (authorised, recruitment pending).
Therapeutic area(s): Diseases [C] - Respiratory Tract Diseases [C08]
Gender: Female, Male. Age: 0-17 years. Enrolment: 20.
Start date (EU): 2026-07-21. Decision date: 2026-07-07. Results received: No. Last updated: 2026-07-13.
Decision dates by country: BE: 2026-07-07, CZ: 2026-07-07, DK: 2026-07-07, FI: 2026-07-10, FR: 2026-07-10, DE: 2026-07-09, GR: 2026-07-07, IT: 2026-07-07, PT: 2026-07-10, ES: 2026-07-10, NL: 2026-07-10, PL: 2026-07-13

Condition(s): Fibrosing interstitial lung disease
Product: BI 1015550, Placebo, BI 1015550, NERANDOMILAST

Primary endpoint: "AUCT,SS based on sampling at steady state using rich sampling (at Week 2 in Part A and at Week 28 in Part B) in participants from 6 years to less than 18 years and sparse sampling (at Week 2 of Part A) in participants younger than 6 years ", Occurrence of a treatment-emergent adverse event (Yes/No) up to Week 26
Endpoint(s): Absolute change from baseline in oxygen saturation (SpO2) [%] on room air at rest at Week 26 and Week 52, Absolute change from baseline in height [cm] at Week 26 and Week 52, Absolute change from baseline in PedsQL™ at Week 26 and Week 52, Occurrence of a treatment-emergent adverse event (Yes/No) over the whole trial, Time to first respiratory-related hospitalisation [days] over the whole trial, Time to first acute ILD exacerbation or death [days] over the whole trial, Time to death [days] over the whole trial, Acceptability based on number/size of tablets at Week 2 and Week 26, Acceptability based on the use of the dispenser at Week 2 and Week 26, Absolute change from baseline in FVC [% predicted] at Week 26 and Week 52 (applicable to participants ≥6 years), Absolute change from baseline in 6-min walk distance [m] at Week 26 and Week 52 (applicable to participants ≥6 years)

Source: https://euclinicaltrials.eu/ctis-public/view/2025-523369-32-00